EU clinical trial 2022-502575-30-00: A 2-year Open-label Extension Study to Assess the Long-term Safety and Efficacy of Lebrikizumab in Adult and Adolescent Patients with Moderate-to-Severe Atopic Dermatitis
Protocol code: M-17923-32
Sponsor: Almirall S.A. (Industry). Phase: Therapeutic confirmatory (Phase III). Countries: Germany (ended), Poland (ended).
Therapeutic area(s): Diseases [C] - Skin and Connective Tissue Diseases [C17]
Gender: Female, Male. Age: 0-17 years, 18-64 years, 65+ years. Enrolment: 202.
Status: Ended. Start date (EU): 2023-05-23. End date (EU): 2026-04-23. Decision date: 2023-05-05. Results received: No. Last updated: 2025-07-30.
Decision dates by country: DE: 2023-05-05, PL: 2023-05-08

Condition(s): Atopic Dermatitis
Product: Lebrikizumab

Primary endpoint: Proportion of patients discontinued from study treatment due to treatment-emergent AEs through the last study visit.
Endpoint(s): Percentage of patients with EASI 50, EASI 75, and EASI 90 (≥50%, ≥75%, and ≥90% reduction in EASI scores from baseline of parent study, respectively) by visit., Percentage change from baseline of parent study in EASI score by visit., Percentage of patients with EASI score ≤7 by visit., Percentage of patients achieving IGA 0/1 by visit., Percentage of patients achieving Pruritus NRS score of 0/1 by visit., Percentage of patients achieving Pruritus NRS score ≤4 by visit., Percentage change from baseline of parent study* in POEM by visit., Percentage change from baseline of parent study* in BSA involvement by visit., Proportion of TCS-free days from baseline by visit., Percentage of patients with DLQI ≥4 at baseline achieving ≥ 4-point improvement from baseline of parent study in DLQI score by visit, Percentage of patients with CDLQI ≥6 at baseline achieving ≥6-point improvement from baseline of parent study* in CDLQI score by visit., Percentage of participants achieving DLQI ≤5 by visit, Percentage of participants achieving CDLQI ≤6 by visit.

Source: https://euclinicaltrials.eu/ctis-public/view/2022-502575-30-00